EU clinical trial 2024-514416-28-00: An investigator-initiated, multicenter, open-label, parallel arm, active comparator, randomized study to compare the efficacy of apixaban versus warfarin with respect to thrombus resolution in patients with left ventricular thrombus after acute myocardial infarction.
Sponsor: Karolinska Institutet (Educational Institution). Phase: Therapeutic use (Phase IV). Countries: Sweden (ongoing, recruiting), Denmark (authorised, recruitment pending).
Therapeutic area(s): Diseases [C] - Cardiovascular Diseases [C14]
Gender: Female, Male. Age: 18-64 years, 65+ years. Enrolment: 287.
Start date (EU): 2025-04-09. Decision date: 2024-11-04. Results received: No. Last updated: 2026-03-31.
Decision dates by country: SE: 2024-11-04, DK: 2026-03-31

Condition(s): Left ventricular thrombosis., Acute mycocardial infarction (AMI)
Product: Eliquis 5 mg film-coated tablets, Waran 2,5 mg tabletter, OPTISON 0.19 mg/ml dispersion for injection, SonoVue 8 microlitres/mL powder and solvent for dispersion for injection, Eliquis 2.5 mg film-coated tablets

Primary endpoint: Thrombus resolution will be evaluated by TTE (Transthoracic echocardiogram), preferably contrast-enhanced, at 3 months. Should TTE be inconclusive, cardiac magnet resonance imaging (MRI) or cardiac computed tomography (CCT) is recommended to evaluate the primary endpoint.
Endpoint(s): Clinically relevant bleeding - BARC (Bleeding Academy Research Consortium) 2, 3 or 5 bleeding., Major bleeding BARC 3 or 5 bleeding., Individual bleeding endpoints (Fatal bleeding, intracranial hemorrhage, GI bleeding, urogenital bleeding and bleeding of other sources)., Major adverse cardiovascular events (MACE). Composite of non-fatal myocardial infarction, non-fatal ischemic stroke and cardiovascular death., Net clinical benefit: Composite of MACE and BARC 2, 3 or 5 bleeding., Ischemic stroke and systemic embolism., Recurrence of LV thrombus at 12 months.

Source: https://euclinicaltrials.eu/ctis-public/view/2024-514416-28-00